EU clinical trial 2023-508883-31-00: An Open-Label, Multicenter, Long-term Extension Study of Treatment With Tislelizumab, Pamiparib, and Other Investigational Agents in Patients With Advanced Malignancies
Protocol code: BGB-A317-290-LTE1
Sponsor: BeOne Medicines AG (Pharmaceutical company). Phase: Therapeutic confirmatory (Phase III). Countries: Italy (ended), Poland (ended), France (ended).
Therapeutic area(s): Diseases [C] - Hemic and Lymphatic Diseases [C15]; Diseases [C] - Neoplasms [C04]
Gender: Female, Male. Age: 18-64 years, 65+ years. Enrolment: 21.
Status: Ended. Start date (EU): 2021-02-23. End date (EU): 2026-04-09. Decision date: 2024-03-08. Results received: No. Last updated: 2026-05-25.
Decision dates by country: IT: 2024-03-11, FR: 2024-03-08, PL: 2024-03-20

Condition(s): Solid tumors and hamatological malignancies
Product: Pamiparib, Ociperlimab, Ociperlimab, Tislelizumab, Pamiparib

Primary endpoint: Safety as assessed by incidence of all AEs of special interest, Grade 3, 4, or 5 AEs, Grade 2 AEs that affect vital organs (eg, heart, liver, brain, lung, kidney), nonserious AEs that lead to dose modification or drug discontinuation or withdrawal from the trial, and SAEs of any severity.
Endpoint(s): Overall survival defined as the time from start of treatment in parent study (or randomization date for a randomized study) until the date of death from any cause.

Source: https://euclinicaltrials.eu/ctis-public/view/2023-508883-31-00